EU clinical trial 2025-522741-21-00: Heart rate control: Betablockers or Ivabradine therapy before cardiac computed tomography
Sponsor: Region Midtjylland (Hospital/Clinic/Other health care facility). Phase: Therapeutic use (Phase IV). Countries: Denmark (ongoing, recruiting).
Therapeutic area(s): Diseases [C] - Cardiovascular Diseases [C14]
Gender: Female, Male. Age: 18-64 years, 65+ years. Enrolment: 350.
Status: Ongoing, recruiting. Start date (EU): 2025-12-09. Decision date: 2025-10-01. Results received: No. Last updated: 2026-02-11.

Condition(s): ischemic heart disease
Product: IVABRADINE, ATENOLOL, METOPROLOL

Primary endpoint: The primary end point measure is the time to a heart rate (mean) lowered by 10% from baseline after adminstration of study drug

Source: https://euclinicaltrials.eu/ctis-public/view/2025-522741-21-00